EU clinical trial 2024-516745-39-00: A Phase 2b, Randomized, Double-blind, Placebo-controlled Study to Assess the Safety, Tolerability, and Efficacy of IMVT-1402 in Participants with Active Subacute Cutaneous Lupus Erythematosus (SCLE) and/or Chronic Cutaneous Lupus Erythematosus (CCLE) With or Without Systemic Manifestations.
Protocol code: IMVT-1402-2701
Sponsor: Immunovant Sciences GmbH (Pharmaceutical company). Phase: Therapeutic exploratory (Phase II). Countries: Greece (ongoing, recruitment ended), Spain (ongoing, recruitment ended), Poland (ongoing, recruitment ended), Germany (ongoing, recruitment ended), Bulgaria (ongoing, recruitment ended).
Therapeutic area(s): Diseases [C] - Immune System Diseases [C20]
Gender: Female, Male. Age: 18-64 years, 65+ years. Enrolment: 46.
Status: Ongoing, recruitment ended. Start date (EU): 2025-07-11. Decision date: 2025-06-24. Results received: No. Last updated: 2026-06-22.
Decision dates by country: BG: 2025-06-26, GR: 2025-06-25, ES: 2025-06-24, PL: 2025-06-30, DE: 2025-06-25

Condition(s): Cutaneous lupus erythematosus
Product: IMVT-1402, Placebo is identical to the IMP but with no active substance.

Primary endpoint: Percent change from Period 1 baseline in CLASI-A score at Week 12.
Endpoint(s): Proportion of participants who have a reduction in CLASI-A score of ≥ 5 points from Period 1 Baseline at Week 12, Proportion of participants who have a reduction in CLASI-A score of ≥ 50% from Period 1 Baseline at Week 12, Proportion of participants who have a reduction in CLASI-A score of ≥ 70% from Period 1 Baseline at Week 12

Source: https://euclinicaltrials.eu/ctis-public/view/2024-516745-39-00